EU clinical trial 2025-524043-12-00: A study to learn more about the safety and effects of a new blood-thinning medicine, given alone and together with another blood-thinner, in healthy adults
Protocol code: 22806
Sponsor: Bayer AG (Pharmaceutical company). Phase: Human Pharmacology (Phase I)- Other. Countries: Germany (ongoing, recruiting).
Therapeutic area(s): Diseases [C] - Cardiovascular Diseases [C14]
Gender: Female, Male. Age: 18-64 years. Enrolment: 72.
Status: Ongoing, recruiting. Start date (EU): 2026-05-13. Decision date: 2026-04-15. Results received: No. Last updated: 2026-04-15.

Condition(s): atrial fibrillation, transient ischemic attack (TIA), ischemic stroke

Source: https://euclinicaltrials.eu/ctis-public/view/2025-524043-12-00